EU clinical trial 2024-513976-16-00: Phase III trial of laryngeal preservation comparating Induction chemotherapy with cisplatin, 5-fluorouracil and docetaxel (TPF) followed by radiotherapy and concomitant administration of radiotherapy with cisplatin (SALTORL).
Sponsor: Groupe Oncologie Radiotherapie Tete Cou (Patient organisation/association). Phase: Therapeutic confirmatory (Phase III). Countries: France (ongoing, recruitment ended).
Therapeutic area(s): Diseases [C] - Neoplasms [C04]
Gender: Female, Male. Age: 18-64 years, 65+ years. Enrolment: 256.
Status: Ongoing, recruitment ended. Start date (EU): 2015-06-26. Decision date: 2024-07-15. Results received: No. Last updated: 2024-07-15.

Condition(s): squamous cell carcinomas of the larynx or hypopharynx locally advance
Product: Docetaxel Accord 20 mg/1 ml concentrate for solution for infusion, Fluorouracil 50 mg/ml Solution for Injection or Infusion, CISPLATINE ACCORD 1 mg/ml, solution à diluer pour perfusion, Cisplatin 1 mg/ml concentrate for solution for Infusion

Primary endpoint: Survival with preservation of laryngeal and pharyngoesophageal function. The following events are considered: death, total laryngectomy, tracheotomy at 24 months, gastric tube at 24 months, local recurrence not accessible to salvage treatment. The causes of death will be specified
Endpoint(s): Overall survival. Events are considered to be: death from any cause., Survival without recurrence. Events are considered: death from any cause, local recurrence, lymph node recurrence, distant metastases, Locoregional control. Events are considered: local recurrence, lymph node recurrence, Metastasis-free survival and incidence of metastases, Survival with preservation of laryngeal and pharyngoesophageal function according to dynamic swallowing videoscopy, Laryngeal preservation. Total laryngectomy is considered an event, Response rate to induction chemotherapy, Toxicity of the treatments under study. By distinguishing between acute and late toxicities, Feasibility and morbidity of salvage surgery: evaluation of the number of recurrences that could be successfully treated by salvage surgery and description of the operative consequences., Qualité de la fonction laryngée et pharyngo-oesophagienne. Seront évaluées par échelle qualitative : la voix, la déglutition (y compris le type d’alimentation) et la respiration au repos et à l’effort. La qualité de la réhabilitation des patients laryngectomisés sera également analysée.

Source: https://euclinicaltrials.eu/ctis-public/view/2024-513976-16-00